EU clinical trial 2024-515532-72-00: Precision Immuno-Oncology for advanced Non-small cell lung cancer patients with PD-1 ICI Resistance (PIONeeR clinical study)
Protocol code: PIONeeR TRIAL
Sponsor: Centre Hospitalier Regional De Marseille (Hospital/Clinic/Other health care facility). Phase: Therapeutic exploratory (Phase II). Countries: France (ended).
Therapeutic area(s): Diseases [C] - Respiratory Tract Diseases [C08]
Gender: Female, Male. Age: 18-64 years, 65+ years. Enrolment: 130.
Status: Ended. Start date (EU): 2019-10-08. End date (EU): 2025-08-11. Decision date: 2024-09-25. Results received: No. Last updated: 2025-08-19.

Condition(s): non small cell lung cancer
Product: AZD6738, Savolitinib, Ceralasertib, DURVALUMAB, Monalizumab, DOCETAXEL, AZD6738, Oleclumab

Primary endpoint: the determination of 12-week Disease Control Rate (DCR) assessed in each arm of treatment
Endpoint(s): the proportion of patients with complete response (CR) or partial response (PR) as best overall response over the treatment period., The Progression-free survival

Source: https://euclinicaltrials.eu/ctis-public/view/2024-515532-72-00